EU clinical trial 2023-503531-18-00: Multicentre, open-label, randomised, two-arm, parallel-group, superiority trial to assess bioavailability and practicability of two once-daily tacrolimus formulations, Envarsus® compared with Advagraf™, administered in kidney transplant recipients
Protocol code: TaC:Drop
Sponsor: Universitaetsklinikum Regensburg (Hospital/Clinic/Other health care facility). Phase: Therapeutic use (Phase IV). Countries: Germany (ongoing, recruitment ended).
Therapeutic area(s): Phenomena and Processes [G] - Immune system processes [G12]
Gender: Female, Male. Age: 18-64 years, 65+ years. Enrolment: 300.
Status: Ongoing, recruitment ended. Start date (EU): 2024-02-13. Decision date: 2023-09-19. Results received: No. Last updated: 2026-05-26.

Condition(s): Prophylaxis of transplant rejection in adult kidney allograft recipients
Product: Envarsus 4 mg prolonged-release tablets, Envarsus 0.75 mg prolonged-release tablets, Advagraf 0.5 mg prolonged-release hard capsules, Advagraf 5 mg prolonged-release hard capsules, Advagraf 3 mg prolonged-release hard capsules, Advagraf 1 mg prolonged-release hard capsules, Envarsus 1 mg prolonged-release tablets

Primary endpoint: Dose-normalised trough level (C/D ratio) measured at 12 weeks post-transplantation.
Endpoint(s): Time to reach the first trough level in target range, Proportion of patients with trough levels lower, within, or higher than the target range at day 4, day 14, day 28 and week 12, Mean tacrolimus trough level and inter-patient variability (range) of tacrolimus trough levels at day 4, day 14, day 28 and week 12, Mean daily dose of tacrolimus and inter-patient variability (range) of tacrolimus daily dose at day 4, day 14, day 28 and week 12, C/D ratio measured at day 4, day 14, day 28, and at 1, 2 and 3 years, Intra-patient variability of C/D ratio and daily dose over the time points: day 4, day 14, day 28 and week 12, Treatment failure rate, which is a composite endpoint of biopsy-proven acute rejection (BPAR), graft failure (defined as initiation of renal dialysis or re-transplantation) or death (from any cause), measured at 12 weeks and at 1, 2, 3 years, Time to treatment failure (composite endpoint of BPAR, graft failure2 or death) after transplantation, Incidence rate, severity and time to clinically-confirmed BPAR3 at 12 weeks and at 1, 2, 3 years, Incidence rate of graft failure (defined as initiation of renal dialysis or re-transplantation) at 12 weeks and at 1, 2, 3 years, Mortality rate (death from any cause) at 12 weeks and at 1, 2, 3 years, Graft function measured by eGFR (estimated glomerular filtration rate) calculated according to the CKD-EPI formula at day 4, day 14, day 28, week 12, and at 1, 2, 3 years, Incidence rate of for-cause biopsies at 12 weeks, Incidence rate of acute rejection episodes requiring treatment at 12 weeks, Incidence rate of steroid-resistant BPAR episodes at 12 weeks and at 1 year, Incidence rate of delayed graft function (DGF), defined as the need for more than one episode of dialysis after transplantation, Incidence rate of primary non-function (PNF) of the renal allograft, defined as the necessity for ongoing chronic dialysis, Incidence of hepatotoxicity (GPT or GOT levels ≥ 2.5 x upper limit of normal range) at 12 weeks and at 1, 2, 3 years, Incidence of CMV and BKV infection (including organ manifestation, if relevant) at 12 weeks and at 1 year, Incidence, type, severity and seriousness of adverse reactions (ARs) at 12 weeks and at 3 years, Blood pressure at 12 weeks and at 1, 2, 3 years, Incidence of de novo tremor (incidence and severity based on medical assessment by investigator) at 12 weeks and at 3 years, Incidence of gastrointestinal disorders requiring diagnostic investigation at 12 weeks and at 3 years, Incidence of new onset diabetes mellitus after transplantation (NODAT), defined as HbA1c ≥ 6.5% or 47.5 mmol/mol or fasting plasma glucose ≥ 126 mg/dl on two separate occasions, at 12 weeks and at 1, 2, 3 years, Recurrence of primary kidney disease at 12 weeks and at 3 years, Incidence of de novo DSA detected within 1 year post-transplantation, Patient-reported health-related quality-of-life measured using the Kidney Transplant Questionnaire-34 (KTQ-34) at 12 weeks and at 3 years, Doses and duration of glucocorticosteroid treatment at 12 weeks and at 1, 2, 3 years, Dose of mycophenolate (both formulations) at 12 weeks and at 1, 2, 3 years, Incidence and time to study treatment discontinuation, Incidence, time to and reason for patient withdrawal from study

Source: https://euclinicaltrials.eu/ctis-public/view/2023-503531-18-00